EU clinical trial 2023-508081-15-00: A phase II trial of tisagenlecleucel in first-line high-risk (HR) pediatric and young adult patients with B-cell acute lymphoblastic leukemia (B-ALL) who are minimal residual disease (MRD) positive at the end of consolidation (EOC) therapy
Protocol code: CCTL019G2201J
Sponsor: Novartis Pharma AG (Pharmaceutical company). Phase: Therapeutic exploratory (Phase II). Countries: Belgium (ongoing, recruitment ended), Norway (ongoing, recruitment ended), Spain (ongoing, recruitment ended), France (ongoing, recruitment ended), Netherlands (ongoing, recruitment ended), Italy (ongoing, recruitment ended), Sweden (ongoing, recruitment ended), Denmark (ongoing, recruitment ended).
Therapeutic area(s): Diseases [C] - Neoplasms [C04]
Gender: Female, Male. Age: 0-17 years, 18-64 years. Enrolment: 24.
Status: Ongoing, recruitment ended. Start date (EU): 2019-04-04. Decision date: 2024-03-01. Results received: No. Last updated: 2026-02-02.
Decision dates by country: NO: 2024-03-01, IT: 2024-04-09, SE: 2024-03-04, FR: 2024-03-01, ES: 2024-03-04, NL: 2024-03-04, BE: 2024-03-11, DK: 2024-03-01

Condition(s): High-risk B-cell acute lymphoblastic leukemia
Product: TISAGENLECLEUCEL

Primary endpoint: 4-year OS rate. OS defined as the time from date of first tisagenlecleucel infusion to the date of death due to any reason, 5-year DFS rate without censoring for new anticancer therapy, including SCT, while in remission. DFS, defined as the time from tisagenlecleucel infusion to morphologic relapse, occurrence of secondary malignancy or death due to any cause, whichever occurs first
Endpoint(s): Proportion of subjects who are disease free without allogeneic SCT at 1 year, 5-year DFS rate censoring for new anticancer therapy, including SCT, while in remission, Proportion of subjects achieving MRD negative CR or CRi at month 3 post-tisagenlecleucel infusion, Proportion of subjects in CR or CRi with persistent B-cell aplasia over time post tisagenlecleucel infusion, Proportion of subjects who have tisagenlecleucel product successfully manufactured (meet all release criteria) over the total number of subjects enrolled for the age ≥ 1 year and < 3 years at respective time points, Pediatric Quality of Life Questionnaire (PedsQL) 4.0 and European Quality of Life Questionnaire (EuroQol) EQ-5D in subjects ≥ age 8 years; change from baseline, Cogstate computerized cognitive battery age standardized scores (5 tests: psychomotor function (DET), attention (IDN), working memory (ONB), visual learning (OCL) and executive function (GML) (in subjects ≥ age 6 years), Evaluation of adverse events, vital signs, laboratory and other parameters, • Prevalence and incidence of pre-existing and treatment induced immunogenicity • Pre-existing and treatment induced immunogenicity on clinical response, cellular kinetics (Cmax, AUC0-29d, Clast) and safety, • Tisagenlecleucel transgene levels by qPCR in blood, bone marrow, and CSF if available • Expression of tisagenlecleucel detected by flow cytometry in blood and bone marrow • Cmax, Tmax, AUCs and other relevant cellular kinetic parameters in blood, bone-marrow, and CSF if available, B-cell recovery time and transgene levels over time, • Response endpoints (e.g. DFS, OS, Month 3 response) and key safety events (e.g. CRS, neurological events, cytopenias) and relationships with dose • Response endpoints (e.g. DFS, OS, Month 3 response) and key safety events (e.g. CRS, neurological events, cytopenias) and relationship with relevant exposure parameters (e.g. AUC and Cmax) • Cellular kinetic parameters and relationship with dose

Source: https://euclinicaltrials.eu/ctis-public/view/2023-508081-15-00